EU clinical trial 2024-519436-17-00: A randomized, placebo-controlled, double-blind clinical trial evaluating the safety and efficacy of parecoxib in hospitalized patients with spontaneous subarachnoid hemorrhage
Protocol code: PAR-FNUSA-2024
Sponsor: Fakultni Nemocnice U Sv Anny V Brne (Hospital/Clinic/Other health care facility). Phase: Therapeutic exploratory (Phase II). Countries: Czechia (ongoing, recruiting).
Therapeutic area(s): Diseases [C] - Nervous System Diseases [C10]
Gender: Female, Male. Age: 18-64 years, 65+ years. Enrolment: 112.
Status: Ongoing, recruiting. Start date (EU): 2025-12-15. Decision date: 2025-02-18. Results received: No. Last updated: 2026-06-16.
Decision dates by country: CZ: 2025-04-15

Condition(s): spontaneous subarachnoid hemorrhage
Product: Dynastat 40 mg powder and solvent for solution for injection, Fyziologický roztok Viaflo

Primary endpoint: The primary outcome measure is the percentage of patients in the active and control groups whose outcome is categorized as favorable (mRS 0-3) or unfavorable (mRS 4-6) according to the modified Rankin Scale (mRS).
Endpoint(s): The secondary monitored parameter is the percentage of patients in the active and control groups whose outcome, according to the modified Rankin scale (mRS), is divided into favourable (mRS 0-3) or unfavourable (mRS 4-6)., Number of patients with vasospasms confirmed on TCD / CT AG / MR AG / DSA, Number of patients with delayed ischemic neurological deficit, Number of deaths, Length of hospitalization in ICU, Total length of hospitalization, Number of patients with acute hydrocephalus, Number of patients with chronic hydrocephalus with V-P shunt implantation, Number of patients with fever above 38 degrees Celsius, Evaluation of the systemic inflammatory response (assessed daily during hospitalization) meeting at least 2 parameters: heart rate > 90/min., leukocytosis > 12x109/l) or leukopenia < 9x109, respiratory rate > 20/min. or PaCO2 < 32 mm Hg (4.3 kPa), body temperature < 36.0 °C or > 38.0 °C, The comparison of the patients in the treatment and placebo arm with pain according to the Visual Analogue Scale, a numerical scale from 0 to 10 points, where increasing pain is indicated by a higher score., Evaluation of prostaglandins (COX-2, PGH2, PGI2, PGE2, PGD2, PF2a, TXA2) and pro-inflammatory cytokines (TNF, IL-1, IL-4, IL-6, IL-8, IL-12) in the cerebrospinal fluid in the case of the below-mentioned external ventricular drainage after 2 days and in the serum regardless of the established cerebrospinal fluid drainage after two days to day 10 from initial symptoms, C-reactive protein (CRP), procalcitonin (PCT) and white blood cell count, This evaluation will compare the number of patients in the treatment and placebo arms who undergo cerebrospinal fluid drainage., Evaluation of quality of life (SF-36 score), Number of patients with inflamation based on source of bleeding, Percentage of patients in the experimental and placebo groups with the occurrence of serious adverse events (SAE) (assessed during hospitalization, at discharge, 3 and 6 months after the first dose) supplemented by evaluation in individual subgroups according to the source of bleeding., Percentage of patients in the experimental and placebo groups with an increase in blood creatine phosphokinase (CPK), an increase in blood lactate dehydrogenase (LDH), an increase in alanine transaminase (ALT), an increase in aspartate transaminase (AST), and an increase in blood urea level > 5x ULN; separate analysis for subgroups by source of bleeding.

Source: https://euclinicaltrials.eu/ctis-public/view/2024-519436-17-00